EU clinical trial 2023-504845-30-00: A Modular, Multi-part, Multi-arm, Open-label, Phase I/II Study to Evaluate the Safety and Tolerability of GRWD5769 Alone and in Combination with Anticancer Treatments in Patients with Solid Malignancies
Protocol code: GRWD5769-ST-01
Sponsor: Grey Wolf Therapeutics Limited (Pharmaceutical company). Phase: Phase I and Phase II (Integrated)- First administration to humans. Countries: Spain (ongoing, recruiting), France (ongoing, recruiting).
Therapeutic area(s): Diseases [C] - Neoplasms [C04]
Gender: Female, Male. Age: 18-64 years, 65+ years. Enrolment: 175.
Status: Ongoing, recruiting. Start date (EU): 2023-10-05. Decision date: 2023-08-28. Results received: No. Last updated: 2026-06-15.
Decision dates by country: FR: 2025-01-29, ES: 2023-08-28

Condition(s): Solid malignancies
Product: GRWD5769, GRWD5769, LIBTAYO 350 mg concentrate for solution for infusion., GRWD5769

Primary endpoint: Incidence, type and severity of treatment-emergent and treatment-related adverse events (AEs), Incidence and nature of DLTs or events meeting the DLT criteria, Comparative efficacy will be evaluated using the change in dimension over time of RECIST Target Lesions from baseline and on-study scans recorded at weeks 8 and 16.
Endpoint(s): The MTD will be determined by the incidence of DLTs according to the MTD evaluation process., The RP2D will be determined based on the safety, tolerability, PK, PDc and preliminary efficacy data of GRWD5769. The RP2D will not exceed the MTD., Pharmacokinetic parameters to be evaluated (where possible) include (but are not limited to): • Trough concentrations • Maximum observed concentration (Cmax) • Time to Cmax (Tmax) • Trough concentrations • Area under the concentration-time curve (AUC last) • Half-life (t1/2) • Oral clearance (CL/F) • Apparent volume of distribution after oral administration (Vz/F), RECIST 1.1 or iRECIST defined tumour response, including the frequency, quality and durability of response per RECIST 1.1 or iRECIST criteria. Specific endpoints include (but are not limited to): o Tumour size o Objective response rate (ORR) o Disease control rate (DCR) o Rate of participants with stable disease (stable disease rate [SDR]), defined as the proportion of participants with stable disease of at least 16 weeks per RECIST 1.1 or iRECIST o Time to response (TTR) - please see protocol, Change from baseline in disease-specific tumour markers (e.g. CA-125 for ovarian cancer, PSA for prostate cancer), The MBAD is defined as the dose that achieves one of the following: a. Average total daily plasma (Cssave) of 3899 ng/mL b. A partial or complete RECIST 1.1 or iRECIST assessed response in at least one participant c. A clinically significant reduction (in the opinion of the safety review committee [SRC]), compared to baseline, in a tumour specific marker measured in at least one participant, Safety and tolerability endpoints include: • Incidence, type and severity of treatment-emergent and treatment-related adverse events (AEs) • Incidence and nature of events meeting the DLT criteria, Overall survival (Module 2 Part C and Module 2 Part D only)

Source: https://euclinicaltrials.eu/ctis-public/view/2023-504845-30-00